EU clinical trial 2024-512483-59-00: TRACK - Treatment of cardiovascular disease with low dose Rivaroxaban in Advanced CKD.
Protocol code: TRACK_001
Sponsor: The George Institute For Global Health (Laboratory/Research/Testing facility). Phase: Therapeutic confirmatory (Phase III). Countries: Germany (ended), Belgium (ended), France (ended).
Therapeutic area(s): Diseases [C] - Cardiovascular Diseases [C14]
Gender: Female, Male. Age: 18-64 years, 65+ years. Enrolment: 450.
Status: Ended. Start date (EU): 2023-06-09. End date (EU): 2025-10-31. Decision date: 2024-06-19. Results received: Yes. Last updated: 2025-01-07.
Decision dates by country: BE: 2024-06-19, DE: 2024-06-20, FR: 2024-06-21

Condition(s): Improvement of cardiovascular outcomes in patients with advanced chronic kidney disease. In easily understood language, this is Heart and blood vessel disease and Kidney disease.
Product: Matching placebo for BAY 597939 2.5 mg filmcoated tablets, Rivaroxaban 2.5 mg

Primary endpoint: •CV death, • non-fatal myocardial infarction, • stroke, or • PAD events
Endpoint(s): 1.3-point MACE , 2.All-cause death, 3.Composite of all-cause death,non-fatal myocardial infarction,or stroke, 4.Composite of all-cause death, non-fatal myocardial infarction, or stroke, or peripheral artery disease event, 5.Individual components of the composite outcomes, 6.Net-clinical-benefit outcome 7. Venous thromboembolism.

Source: https://euclinicaltrials.eu/ctis-public/view/2024-512483-59-00